EU clinical trial 2023-508310-41-00: Minimal Residual Disease-based Strategy with T-Cell Redirector After Treatment with Daratumumab, Bortezomib, Lenalidomide, and Dexamethasone (D-VRd) in Newly Diagnosed Multiple Myeloma: A Phase 2 (IFM 2022-01).
Protocol code: RC23_0267
Sponsor: Centre Hospitalier Universitaire De Nantes (Hospital/Clinic/Other health care facility). Phase: Therapeutic exploratory (Phase II). Countries: France (ongoing, recruitment ended).
Therapeutic area(s): Not possible to specify
Gender: Female, Male. Age: 18-64 years, 65+ years. Enrolment: 103.
Status: Ongoing, recruitment ended. Start date (EU): 2024-06-26. Decision date: 2024-04-03. Results received: No. Last updated: 2026-06-12.
Decision dates by country: FR: 2024-05-17

Condition(s): Multiple myeloma
Product: DARZALEX 1800 mg solution for injection, MONTELUKAST, teclistamab, DEXAMETHASONE, DEXAMETHASONE SODIUM PHOSPHATE, PARACETAMOL, DEXAMETHASONE, VELCADE 3.5 mg powder for solution for injection, JNJ-64407564, LENALIDOMIDE, PREDNISONE, JNJ-64407564, teclistamab

Primary endpoint: • Cohort A only: sustained MRD [-] status at one year (ie, Cycle 13 Day 1). • Cohort B only: conversion to MRD [-] status by one year (ie, Cycle 13 Day 1) Note: MRD assessment at 1 year done after completion of 12 cycles of maintenance therapy, ie, on Cycle 13 Day 1. MRD [-] status is defined by a value of NGS MRD <10-5 and MRD [+] status is defined by a value of NGS MRD ≥10-5.
Endpoint(s): • Presence and severity of TEAEs defined by NCI CTCAE Version 5.0 (Number of TEAEs), except for CRS and ICANS, which will be assessed based on ASTCT guidelines., • Cohort A only: sustained MRD [-] status at one year (ie, Cycle 13 Day 1). • Cohort B only: conversion to MRD [-] status by one year (ie, Cycle 13 Day 1) Note: MRD assessment at 1 year done after completion of 12 cycles of maintenance therapy, ie, on Cycle 13 Day 1. MRD [-] status is defined by a value of NGS MRD <10-6 and MRD [+] status is defined by a value of NGS MRD ≥10-6, • Cohort B only: conversion to MRD [-] status by three months (ie, Cycle 4 Day 1) Note: MRD assessment at 3 months done after completion of 3 cycles of maintenance therapy, ie, on Cycle 4 Day 1. MRD [-] status is defined by a value of NGS MRD <10-5 and MRD [+] status is defined by a value of NGS MRD ≥10-5, • OS: time from the first dose of study drug to the date of death due to any cause • PFS: time from the date of first dose of study drug either PD, or death, whichever occurs first • DOR: time from the first response (PR or better) to the date of disease progression or death due to any cause. • TTR: time from the first dose of study drug to the date of the first response (PR or better), • ORR, (PR or better) as defined by the IMWG response criteria (2016) • VGPR or better, CR or better will be evaluated according to IMWG response criteria, • Value of biological prognostic factors (at Screening), such as: - ISS stage - Cytogenetics as del(17p), t(4;14), t(14;16), t(14;20), amp(1q) and del(1p), • Change in EQ-5D-5L and EORTC QC30 score over time (Screening, C1D1, C3D1, Maintenance C1D1, D1 every 3rd cycle, EOT, FU before PD)

Source: https://euclinicaltrials.eu/ctis-public/view/2023-508310-41-00